EU clinical trial 2024-516960-27-00: A Phase 2a, Open-label, Single-arm Study to Evaluate the Efficacy, Safety, and Tolerability of MORF-057 in Adults with Moderately to Severely Active Ulcerative Colitis (EMERALD-1)
Protocol code: MORF-057-201
Sponsor: Morphic Therapeutic Inc. (Pharmaceutical company). Phase: Therapeutic exploratory (Phase II). Countries: Poland (ended).
Therapeutic area(s): Diseases [C] - Digestive System Diseases [C06]
Gender: Female, Male. Age: 18-64 years, 65+ years. Enrolment: 31.
Status: Ended. Start date (EU): 2022-07-22. End date (EU): 2025-02-19. End date: 2025-02-20. Decision date: 2024-11-11. Results received: Yes. Last updated: 2024-11-11.

Condition(s): Moderately to severely active ulcerative colitis
Product: MORF-057 Capsule

Primary endpoint: Change from baseline to Week 12 in the Robarts Histopathology Index (RHI) Score.
Endpoint(s): 1. Frequencies and proportions for TEAEs, treatment-emergent serious adverse events (TESAEs), and TEAEs leading to study drug discontinuation., 2. Change from baseline to Week 12 in the Modified Mayo Clinic Score (MCS)., 3. MORF-057 concentration in plasma., 4. Plasma PK parameters.

Source: https://euclinicaltrials.eu/ctis-public/view/2024-516960-27-00